EU clinical trial 2025-521388-11-00: Staphylococcus aureus Network Adaptive Platform trial (SNAP)
Protocol code: CLOPI-SNAP
Sponsor: Fundacion Para La Gestion De La Investigacion En Salud De Sevilla (Laboratory/Research/Testing facility). Phase: Therapeutic exploratory (Phase II). Countries: Spain (ongoing, recruiting).
Therapeutic area(s): Diseases [C] - Bacterial Infections and Mycoses [C01]
Gender: Female, Male. Age: 18-64 years, 65+ years. Enrolment: 230.
Status: Ongoing, recruiting. Start date (EU): 2026-07-20. Decision date: 2026-05-04. Results received: No. Last updated: 2026-05-04.

Condition(s): Staphylococcus aureus bacteraemia

Source: https://euclinicaltrials.eu/ctis-public/view/2025-521388-11-00